EU clinical trial 2023-510426-33-00: A PHASE 3, MULTICENTER, RANDOMIZED, DOUBLE-BLIND, PLACEBO-CONTROLLED STUDY OF ORAL OZANIMOD AS MAINTENANCE THERAPY FOR MODERATELY TO SEVERELY ACTIVE CROHN’S DISEASE
Protocol code: RPC01-3203
Sponsor: Celgene International II S.a.r.l. (Pharmaceutical company). Phase: Therapeutic confirmatory (Phase III). Countries: France (ended), Bulgaria (ended), Czechia (ended), Croatia (ended), Slovakia (ended), Latvia (ended), Romania (ended), Poland (ended), Germany (ended), Ireland (ended), Italy (ended), Hungary (ended), Spain (ended), Belgium (ended).
Therapeutic area(s): Diseases [C] - Digestive System Diseases [C06]
Gender: Female, Male. Age: 18-64 years, 65+ years. Enrolment: 351.
Status: Ended. Start date (EU): 2018-09-27. End date (EU): 2024-09-27. End date: 2024-10-03. Decision date: 2024-03-26. Results received: Yes. Last updated: 2024-10-14.
Decision dates by country: BE: 2024-03-27, HR: 2024-03-29, IE: 2024-03-26, ES: 2024-04-01, SK: 2024-03-26, FR: 2024-03-29, IT: 2024-06-04, PL: 2024-06-04, LV: 2024-03-26, DE: 2024-06-04, RO: 2024-04-01, HU: 2024-06-04, BG: 2024-04-19, CZ: 2024-03-27

Condition(s): Moderately to Severely Active Crohn's Disease
Product: Placebo matching Ozanimod hard-gelatin capsules, Ozanimod, Ozanimod

Primary endpoint: Proportion of subjects with a CDAI score of < 150 at Week 52, Proportion of subjects with a Simple Endoscopic Score for Crohn's Disease (SES-CD) decrease from baseline of ≥ 50% at Week 52
Endpoint(s): Proportion of subjects with CDAI reduction from baseline of ≥ 100 points or CDAI score of < 150 at Week 52, Proportion of subjects with average daily abdominal pain score ≤ 1 point and average daily stool frequency ≤ 3 points with abdominal pain and stool frequency no worse than baseline at Week 52, Proportion of subjects with a CDAI score < 150 at Week 52, while remaining corticosteroid free in the prior 12 weeks, Proportion of subjects with a CDAI score of < 150 at Week 52 in subjects with a CDAI score < 150 at pre-randomization, Proportion of subjects with a CDAI score of < 150 at Week 52 and at ≥ 80% of visits between Week 8 and Week 52, inclusive, in subjects with a CDAI score < 150 at pre randomization, Proportion of subjects with absence of ulcers ≥ 0.5 cm with no segment with any ulcerated surface ≥ 10% at Week 52, Histologic improvement based on differences between ozanimod and placebo in histologic disease activity scores (ie, Global Histologic Disease Activity Score [GHAS] changes (Geboes, 2000)) at Week 52, Proportion of subjects with average daily abdominal pain score ≤ 1 point, and average daily stool frequency score ≤ 3 points with abdominal pain and stool frequency no worse than baseline and an SES-CD decrease from baseline of ≥ 50% at Week 52, Proportion of subjects with CDAI score of < 150 and SES-CD decrease from baseline of ≥ 50% at Week 52, Proportion of subjects with average daily abdominal pain score ≤ 1 point, and average daily stool frequency scor≤ 3 points with abdominal pain and stool frequency no worse than baseline and an SES-CD ≤ 4 points and a SES-Ce D decrease ≥ 2 points at Week 52, Proportion of subjects with CDAI reduction from baseline of ≥ 100 points or CDAI score < 150 and SES-CD decrease from baseline of ≥ 50% at Week 52, Proportion of subjects with CDAI score < 150 at Week 12 and SES-CD decrease from baseline of ≥ 50% at Week 52, Proportion of subjects with CDAI reduction from baseline of ≥ 70 points at Week 52, Proportion of subjects with mucosal healing (SES-CD ≤ 4 points and a SES-CD decrease ≥ 2 points) and histologic improvement by GHAS or Robarts Histologic Index (RHI) at Week 52, Time to relapse (an increase in the CDAI score from Maintenance Day 1 of ≥ 100 points and a CDAI score > 220, SES-CD score ≥ 6 [or ≥ 4 if isolated ileal disease]), and exclusion of other causes of an increase in disease activity unrelated to underlying CD (eg, infections, change in medication), Proportion of subjects with a Crohn's Disease Endoscopic Index of Severity (CDEIS) decrease from baseline of ≥ 50% at Week 52

Source: https://euclinicaltrials.eu/ctis-public/view/2023-510426-33-00